EU clinical trial 2023-504896-26-00: A Phase 1 Study of JNJ-79032421 Targeting Mesothelin for Advanced Stage Solid Tumors
Sponsor: Janssen - Cilag International (Pharmaceutical company). Phase: Human Pharmacology (Phase I)- First administration to humans. Countries: Spain (ended).
Therapeutic area(s): Diseases [C] - Neoplasms [C04]
Gender: Female, Male. Age: 18-64 years, 65+ years. Enrolment: 80.
Status: Ended. Start date (EU): 2024-02-09. End date (EU): 2025-06-23. Decision date: 2024-01-09. Results received: No. Last updated: 2025-06-13.

Condition(s): Advanced Stage Solid Tumors

Source: https://euclinicaltrials.eu/ctis-public/view/2023-504896-26-00